EU clinical trial 2023-505993-14-00: A Phase III, Randomised, Open-label, Multicentre, Global Study of Datopotamab Deruxtecan (Dato-DXd) in Combination With Durvalumab and Carboplatin Versus Pembrolizumab in Combination With Platinum-based Chemotherapy for the First-line Treatment of Patients With Locally Advanced or Metastatic NSCLC Without Actionable Genomic Alterations (D926NC00001; AVANZAR)
Protocol code: D926NC00001
Sponsor: Astrazeneca AB (Pharmaceutical company). Phase: Therapeutic confirmatory (Phase III). Countries: Spain (ongoing, recruitment ended), Austria (ongoing, recruitment ended), Sweden (ongoing, recruitment ended), Poland (ongoing, recruitment ended), Italy (ongoing, recruitment ended), France (ongoing, recruitment ended), Bulgaria (ongoing, recruitment ended), Hungary (ongoing, recruitment ended), Germany (ongoing, recruitment ended), Greece (ongoing, recruitment ended).
Therapeutic area(s): Diseases [C] - Neoplasms [C04]
Gender: Female, Male. Age: 18-64 years, 65+ years. Enrolment: 442.
Status: Ongoing, recruitment ended. Start date (EU): 2023-01-05. Decision date: 2024-06-04. Results received: No. Last updated: 2026-06-22.
Decision dates by country: IT: 2024-06-17, DE: 2024-06-06, AT: 2024-06-04, PL: 2024-06-17, BG: 2024-06-14, ES: 2024-06-10, FR: 2024-06-07, GR: 2024-07-17, HU: 2024-06-04, SE: 2024-06-04

Condition(s): Non-Small Cell Lung Cancer (NSCLC)
Product: IMFINZI 50 mg/mL concentrate for solution for infusion., MYCOPHENOLATE MOFETIL, PACLITAXEL, CARBOPLATIN, PEMBROLIZUMAB, Datopotamab deruxtecan, INFLIXIMAB, CISPLATIN, PEMETREXED

Primary endpoint: Progression-Free Survival as assessed by BICR in non-squamous TROP2 biomarker positive analysis set, defined as time from randomisation until progression per RECIST 1.1 or death due to any cause., Overall Survival in non-squamous TROP2 biomarker positive analysis set, defined as the time from randomisation until the date of death due to any cause, Progression-Free Survival as assessed by BICR in non-squamous full analysis set, defined as time from randomisation until progression per RECIST 1.1 or death due to any cause., Overall Survival in non-squamous full analysis set, defined as the time from randomisation until the date of death due to any cause
Endpoint(s): Progression-Free Survival as assessed by BICR, Overall Survival, Objective Response Rate as determined by BICR, Duration of Response as assessed by BICR and investigator assessment, Progression-Free Survival as assessed by investigator assessment, and Time to second progression or death in ITT and TROP2 biomarker-defined populations, Objective Response Rate as determined by BICR, Duration of Response as assessed by BICR and investigator assessment, Progression-Free Survival as assessed by investigator assessment, and Progression-Free Survival 2 in the non-squamous population, Clinical Outcome Assessments as measured by the NSCLC-SAQ and PROMIS Physical Function short form 8c., Pharmacokinetics and immunogenicity

Source: https://euclinicaltrials.eu/ctis-public/view/2023-505993-14-00